EU clinical trial 2024-515303-19-00: Evaluation of the value of 18F-Fluoromisonidazole (18F-FMISO) positron emission tomography hypoxia imaging in idiopathic pulmonary fibrosis - A non-randomized proof-of-concept study comparing patients with idiopathic pulmonary fibrosis and healthy subjects
Protocol code: FIPOXY
Sponsor: Centre Hospitalier Universitaire De Dijon (Hospital/Clinic/Other health care facility). Phase: Human Pharmacology (Phase I)- Other. Countries: France (ended).
Therapeutic area(s): Diseases [C] - Respiratory Tract Diseases [C08]
Gender: Female, Male. Age: 18-64 years, 65+ years. Enrolment: 20.
Status: Ended. Start date (EU): 2023-03-20. End date (EU): 2025-02-20. Decision date: 2024-08-26. Results received: No. Last updated: 2024-08-26.

Condition(s): idiopathic pulmonary fibrosis

Source: https://euclinicaltrials.eu/ctis-public/view/2024-515303-19-00